EU clinical trial 2024-512555-21-00: A randomized phase III trial assessing a regorafenib-irinotecan combination (REGIRI) versus regorafenib alone in metastatic colorectal cancer patients after failure of standard therapies, according to the A/A genotype of Cyclin D1.
Protocol code: PROICM 2018-01 NEX
Sponsor: Institut Regional Du Cancer De Montpellier (Hospital/Clinic/Other health care facility). Phase: Therapeutic confirmatory (Phase III). Countries: France (ongoing, recruitment ended).
Therapeutic area(s): Diseases [C] - Neoplasms [C04]
Gender: Female, Male. Age: 18-64 years, 65+ years. Enrolment: 78.
Status: Ongoing, recruitment ended. Start date (EU): 2019-09-18. Decision date: 2024-07-02. Results received: No. Last updated: 2025-10-29.

Condition(s): Metastatic colorectal cancer
Product: IRINOTECAN, REGORAFENIB, Stivarga 40 mg film-coated tablets

Primary endpoint: Overall survival presented with its median and confidence interval at 95%, estimated from randomization date to the date of death, whatever the cause, using the Kaplan-Meier method.
Endpoint(s): Progression-free survival (PFS), Time to Deterioration, Disease control rate, Objective response rate, Safety according version 5 of NCI-CTCAE, Quality of life (EORTC QLQ-C30)

Source: https://euclinicaltrials.eu/ctis-public/view/2024-512555-21-00